EU clinical trial 2024-513679-42-00: C5541010 - A PHASE 2A, RANDOMIZED, DOUBLE BLIND, SPONSOR OPEN, PLACEBO CONTROLLED, PARALLEL GROUP, DOSE-RANGING STUDY OF PF 07976016 TO ASSESS SAFETY AND EFFICACY IN ADULT PARTICIPANTS WITH OBESITY
Protocol code: C5541010
Sponsor: Pfizer Inc. (Pharmaceutical company). Phase: Therapeutic exploratory (Phase II). Countries: Hungary (ended), Poland (ended).
Therapeutic area(s): Diseases [C] - Otorhinolaryngologic Diseases [C09]; Diseases [C] - Nutritional and Metabolic Diseases [C18]
Gender: Female, Male. Age: 18-64 years, 65+ years. Enrolment: 53.
Status: Ended. Start date (EU): 2025-04-09. End date (EU): 2026-01-12. End date: 2026-01-13. Decision date: 2025-03-13. Results received: No. Last updated: 2025-11-20.
Decision dates by country: HU: 2025-03-13, PL: 2025-03-16

Condition(s): Obesity, Overweight
Product: Saxenda 6 mg/mL solution for injection in pre-filled pen, Saxenda 6 mg/mL solution for injection in pre-filled pen, Placebo for PF-07976016, Saxenda 6 mg/mL solution for injection in pre-filled pen

Primary endpoint: Percent change from baseline (CFB) in body weight at Week 16.
Endpoint(s): Incidence of treatment-emergent Adverse Events (AEs) [AEs and Serious Adverse Events (SAEs)] o clinically significant abnormal laboratory, vital signs and electrocardiogram (ECG) parameters. o assessment of suicidal ideation and behavior (SIB) and depression symptoms as determined by the Columbia Suicide Severity Rating Scale (C-SSRS) and Patient Health Questionnaire-8 (PHQ-8).

Source: https://euclinicaltrials.eu/ctis-public/view/2024-513679-42-00